EU clinical trial 2024-516176-15-00: A Phase IIb Randomised, Double-blind, Placebo-controlled Study to Evaluate the Efficacy, Safety and Tolerability of Co-administration of AZD9550 and AZD6234 in Participants Living With Obesity or Overweight with Comorbidity
Protocol code: D8460C00004
Sponsor: AstraZeneca AB (Pharmaceutical company). Phase: Therapeutic exploratory (Phase II). Countries: Germany (ended).
Therapeutic area(s): Diseases [C] - Nutritional and Metabolic Diseases [C18]
Gender: Female, Male. Age: 18-64 years, 65+ years. Enrolment: 40.
Status: Ended. Start date (EU): 2025-02-24. End date (EU): 2026-05-11. End date: 2026-05-12. Decision date: 2025-02-04. Results received: No. Last updated: 2026-02-19.
Decision dates by country: DE: 2025-04-08

Condition(s): Investigating obesity or overweight condition correlated to many co-morbidities
Product: CYCLIZINE, CALCIUM CARBONATE, Placebo for azd9550, CALCIUM CITRATE, CALCIUM GLUCONATE, Placebo for azd6234, Placebo for azd9550, AZD6234, GLUCOSE, GLUCAGON, ONDANSETRON

Primary endpoint: Percent change in body weight from baseline after 36 weeks of treatment, Weight loss ≥ 5% from baseline after 36 weeks of treatment
Endpoint(s): Absolute change in body weight from baseline after 36 weeks of treatment, Percent and absolute change in body weight from baseline after 36 weeks of treatment, Weight loss ≥ 5% from baseline after 36 weeks of treatment, Weight loss ≥ 10% and ≥ 15% from baseline after 36 weeks of treatment, Prevalence, incidence and titres of ADAs to AZD9550 andAZD6234 in combination and as monotherapies after 36 weeks of treatment, To evaluate the safety and tolerability of AZD9550 and AZD6234 in combination compared with placebo and with monotherapy

Source: https://euclinicaltrials.eu/ctis-public/view/2024-516176-15-00